EU clinical trial 2023-508177-85-00: A parallel-group, prevention, Phase III, modified double-blind, 2-arm, study to investigate the immunogenicity and describe the safety of a quadrivalent meningococcal conjugate vaccine (MenACYW conjugate vaccine) compared with Nimenrix® when administered in a 1+1 schedule in healthy infants and toddlers at 6 and 12 months of age
Protocol code: MEQ00089
Sponsor: Sanofi Pasteur (Pharmaceutical company). Phase: Therapeutic confirmatory (Phase III). Countries: Finland (ended), Poland (ended), Germany (ended), Romania (ended), Denmark (ended), Czechia (ended).
Therapeutic area(s): Diseases [C] - Bacterial Infections and Mycoses [C01]
Gender: Female, Male. Age: 0-17 years. Enrolment: 840.
Status: Ended. Start date (EU): 2024-03-12. End date (EU): 2026-03-13. Decision date: 2024-02-13. Results received: No. Last updated: 2026-01-26.
Decision dates by country: PL: 2024-02-16, DK: 2024-02-13, RO: 2024-02-19, FI: 2024-02-13, CZ: 2024-02-13, DE: 2024-02-15

Condition(s): Healthy volunteers (Meningococcal infection)
Product: Nimenrix powder and solvent for solution for injection in pre-filled syringe Meningococcal groups A, C, W-135 and Y conjugate vaccine, Nimenrix powder and solvent for solution for injection in pre-filled syringe Meningococcal groups A, C, W-135 and Y conjugate vaccine, MenQuadfi solution for injection Meningococcal Group A, C, W and Y conjugate vaccine, Nimenrix powder and solvent for solution for injection in pre-filled syringe Meningococcal groups A, C, W-135 and Y conjugate vaccine, Nimenrix powder and solvent for solution for injection in pre-filled syringe Meningococcal groups A, C, W-135 and Y conjugate vaccine

Primary endpoint: Geometric mean titers (GMTs) of Antibodies against meningococcal serogroups A, C, W and Y, Vaccine Seroresponse to meningococcal serogroups A, C, W and Y assessed by hSBA
Endpoint(s): hSBA antibody titers ≥ 1:8 against meningococcal serogroups A, C, W, and Y, hSBA antibody titers against meningococcal serogroups A, C, W, and Y, hSBA antibody titers ≥ several pre-defined thresholds against meningococcal serogroups A, C, W, and Y, Percentage of Participants who achieved ≥4-fold rise in antibody titers over baseline measured by hSBA, hSBA meningococcal serogroups A, C, W, and Y vaccine seroresponse, Rabbit complement (rSBA) antibody titers against meningococcal serogroups A, C, W, and Y, rSBA antibody titers ≥ several pre-defined thresholds against meningococcal serogroups A, C, W, and Y, Percentage of Participants who achieved ≥4-fold rise in antibody titers over baseline measured by rSBA, rSBA meningococcal serogroups A, C, W, and Y vaccine seroresponse, Number of participants with immediate adverse events (AEs), Number of participants with solicited injection site reactions or systemic reactions, Number of participants with unsolicited AEs, Number of participants with serious adverse events (SAEs)

Source: https://euclinicaltrials.eu/ctis-public/view/2023-508177-85-00